EU clinical trial 2025-521983-36-00: A Phase 2 Study of [68Ga]BED003 for PET Imaging of Fibroblast Activation Protein in Selected Oncology Indications
Protocol code: BED-FAP-201
Sponsor: Blue Earth Diagnostics Ireland Limited (Pharmaceutical company). Phase: Therapeutic exploratory (Phase II). Countries: Netherlands (ongoing, recruiting), Italy (ongoing, recruiting).
Therapeutic area(s): Diseases [C] - Neoplasms [C04]
Gender: Female, Male. Age: 18-64 years, 65+ years. Enrolment: 65.
Status: Ongoing, recruiting. Start date (EU): 2026-06-12. Decision date: 2026-04-28. Results received: No. Last updated: 2026-07-02.
Decision dates by country: IT: 2026-04-30, NL: 2026-04-28

Condition(s): Colorectal cancer (CRC), gastric cancer (GC), pancreatic ductal adenocarcinoma (PDAC), invasive lobular breast cancer (ILC), and epithelial ovarian cancer (EOC).
Product: [68Ga]BED003 injection

Primary endpoint: Co-primary endpoints of sensitivity and specificity of [68Ga]BED003 PET/CT compared to composite standard of truth (SOT; region level: peritoneum).
Endpoint(s): 1. Sensitivity, specificity, positive predictive value, and negative predictive value with [ 68Ga]BED003 PET/CT compared to composite SOT (region and participant level)., 2. Standardised uptake values and tumour-to-background ratios., 3. Adverse events and serious adverse events., 4. Comparison of tumour-to-background ratios and reader assessments of diagnostic quality at 30 and 60 minutes post-[ 68Ga]BED003 injection., 5. Reader assessments of diagnostic quality based on simulated reduced count data.

Source: https://euclinicaltrials.eu/ctis-public/view/2025-521983-36-00